EU clinical trial 2024-512986-15-00: A Phase 2, Multicenter, Randomized, Double-blind, Placebo-controlled, Dose-ranging Study to Evaluate the Efficacy and Safety of Abiprubart in Participants with Sjögren’s Disease
Protocol code: KPL-404-C221
Sponsor: Kiniksa Pharmaceuticals GmbH (Pharmaceutical company). Phase: Therapeutic exploratory (Phase II). Countries: Germany (ended), Hungary (ended), Czechia (ended), Spain (ended), France (ended), Poland (ended).
Therapeutic area(s): Diseases [C] - Eye Diseases [C11]; Diseases [C] - Musculoskeletal Diseases [C05]; Diseases [C] - Skin and Connective Tissue Diseases [C17]; Diseases [C] - Immune System Diseases [C20]; Diseases [C] - Stomatognathic Diseases [C07]
Gender: Female, Male. Age: 18-64 years, 65+ years. Enrolment: 136.
Status: Ended. End date (EU): 2025-02-25. End date: 2025-05-01. Decision date: 2024-12-02. Results received: Yes. Last updated: 2024-12-09.
Decision dates by country: CZ: 2024-12-05, FR: 2024-12-02, DE: 2024-12-04, HU: 2024-12-04, ES: 2024-12-04, PL: 2024-12-09

Condition(s): Sjögren’s Disease
Product: A sterile preservative-free solution with identical composition as the drug product, but without the protein.

Primary endpoint: Change from baseline in European League Against Rheumatism (EULAR) Sjögren’s Disease Activity Index (ESSDAI) at Week 24 (Change from baseline of individual ESSDAI domains will also be reported as supportive information.)
Endpoint(s): Proportion of Sjögren’s Tool for Assessing Response (STAR) responders (≥ 5 points) at Week 24 and evaluation of the individual STAR domains, Change from baseline in ESSDAI over time, Proportion of STAR responders (≥ 5 points) over time, Change from baseline in Stimulated Salivary Flow at Week 24 and over time, Change from baseline in Unstimulated Salivary Flow at Week 24 and over time, Change from baseline in ESSPRI at Week 24 and over time, Change from baseline in Schirmer’s test at Week 24 and over time, Change from baseline in clinESSDAI at Week 24 and over time, Change from baseline in FACIT-Fatigue at Week 24 and over time, Change from baseline in EQ-5D 5L at Week 24 and over time, Incidence of treatment-emergent adverse events (TEAEs), and serious AEs (SAEs), Clinically significant laboratory or electrocardiogram (ECG) changes, Abiprubart serum concentrations over time, and PK parameters, Antidrug antibodies, Receptor occupancy (RO, US clinical sites only)

Source: https://euclinicaltrials.eu/ctis-public/view/2024-512986-15-00